EU clinical trial 2024-511116-25-00: A study to Evaluate AB308 in Combination with AB122 in Participants with Advanced Malignancies (ARC-12)
Protocol code: ARC-12
Sponsor: Arcus Biosciences Inc. (Pharmaceutical company). Phase: Human Pharmacology (Phase I)- First administration to humans. Countries: Spain (ended), Poland (ended).
Therapeutic area(s): Diseases [C] - Neoplasms [C04]
Gender: Female, Male. Age: 18-64 years, 65+ years. Enrolment: 18.
Status: Ended. Start date (EU): 2022-12-13. End date (EU): 2025-08-25. End date: 2025-08-26. Decision date: 2024-05-10. Results received: No. Last updated: 2025-03-06.
Decision dates by country: PL: 2024-05-31, ES: 2024-05-10

Condition(s): Multiple Myeloma, Diffuse large B cell lymphoma (DLBCL), Esophageal Cancer, Gastroesophageal Junction Adenocarcinoma, Melanoma, Advanced Solid Tumor, Gastrointestinal (GI) cancer, Hematological (heme) cancer, Gynecological (Gyn) cancer, Non-small cell lung cancer (NSCLC), Non-Hodgkin Lymphoma, Gastric Cancer, Cervical Cancer

Source: https://euclinicaltrials.eu/ctis-public/view/2024-511116-25-00